EU clinical trial 2024-514643-28-00: Statin Effect on ARrhythmogenic CardiomyopatHy disease progression
Protocol code: SEARCH
Sponsor: Centro Cardiologico Monzino S.p.A. (Hospital/Clinic/Other health care facility). Phase: Therapeutic exploratory (Phase II). Countries: Italy (ongoing, recruiting).
Therapeutic area(s): Diseases [C] - Cardiovascular Diseases [C14]
Gender: Female, Male. Age: 18-64 years, 65+ years. Enrolment: 102.
Status: Ongoing, recruiting. Start date (EU): 2025-03-25. Decision date: 2024-10-11. Results received: No. Last updated: 2025-04-14.

Condition(s): Arrhythmogenic Cardiomyopathy (ACM)
Product: Atorvastatina Teva Italia 80 mg compresse rivestite con film, Film-coated tablets, white, shaped elliptical, and coated with smooth film. The dimensions of each tablet are approximately 18.8 mm x 10.3 mm (identical to those containing atorvastatin).

Primary endpoint: Deterioration from baseline of RV free wall longitudinal strain measured by ECHO
Endpoint(s): Deterioration from baseline of i) arrhythmia burden (PVC, non-sustained and sustained VA, VF, appropriate ICD shocks); ii) other morphological parameters (ventricular volumes, function, both at ECHO and CMR); iii) ECG parameters; iv) blood parameters, Monitoring of AE

Source: https://euclinicaltrials.eu/ctis-public/view/2024-514643-28-00